EU clinical trial 2025-522084-15-00: A Biomarker-Directed, Multi-Centre Phase II/III Study of ctDNA Response Adaptive Immuno-Chemotherapy in Lung Cancer - BR.36
Sponsor: IRCCS Istituto Nazionale Tumori Fondazione Pascale (Hospital/Clinic/Other health care facility). Phase: Phase II and Phase III (Integrated). Countries: Italy (authorised, recruitment pending).
Therapeutic area(s): Diseases [C] - Neoplasms [C04]
Gender: Female, Male. Age: 18-64 years, 65+ years. Enrolment: 36.
Status: Authorised, recruitment pending. Decision date: 2026-01-13. Results received: No. Last updated: 2026-06-10.

Condition(s): metastatic NSCLC patients
Product: CARBOPLATIN, PEMETREXED, CISPLATIN, Abraxane 5 mg/ml powder for dispersion for infusion., PEMBROLIZUMAB, PACLITAXEL

Primary endpoint: progression free survival (PFS) - Overall survival (OS)
Endpoint(s): Feasibility

Source: https://euclinicaltrials.eu/ctis-public/view/2025-522084-15-00